EU clinical trial 2022-501850-12-00: A phase 2B, multicenter, randomized, double-blind, placebo-controlled, dose-finding, efficacy and safety study of HRO350 in subjects with mild-to-moderate psoriasis (the ‘HeROPA’ study)
Protocol code: HRO350-PS-2B HeROPA
Sponsor: Arctic Bioscience AS (Pharmaceutical company). Phase: Therapeutic exploratory (Phase II). Countries: Finland (ended), Germany (ended), Norway (ended), Poland (ended).
Therapeutic area(s): Diseases [C] - Skin and Connective Tissue Diseases [C17]
Gender: Female, Male. Age: 18-64 years, 65+ years. Enrolment: 376.
Status: Ended. Start date (EU): 2023-03-15. End date (EU): 2025-03-07. Decision date: 2023-03-01. Results received: Yes. Last updated: 2025-02-07.
Decision dates by country: DE: 2023-03-06, PL: 2023-03-06, NO: 2023-03-01, FI: 2023-03-01

Condition(s): Psoriasis
Product: BETAMETHASONE VALERATE, Inert refined sunflower oil (998mg) provided in 1000mg fill-weight oblong 20 soft capsules. Other ingredients: 2 mg dl-alpha-tocopherol (antioxidant), red iron oxide (for colorisation), and liquid peach flavour (for aromatization).

Primary endpoint: Proportion of patients with PASI50 (i.e., a ≥50% reduction in PASI score) from baseline to week 26
Endpoint(s): Static PGA (sPGA), BSA, sPGA × BSA product, Scalp PGA (ScPGA) Scale, Use of rescue medication, Dermatology Life Quality Index (DLQI), SF-36, Safety endpoints include adverse events, biochemical and haematological lab tests, discontinuation rates., Psoriasis Symptom Inventory (PSI), Treatment Satisfaction Score (TSS)

Source: https://euclinicaltrials.eu/ctis-public/view/2022-501850-12-00